EU clinical trial 2024-511361-11-00: Brightline-1: A Phase II/III, randomized, open-label, multi-center study of brigimadlin (BI 907828) compared to doxorubicin as first line treatment of patients with advanced dedifferentiated liposarcoma
Protocol code: 1403-0008
Sponsor: Boehringer Ingelheim International GmbH, Boehringer Ingelheim Espana S.A. (Pharmaceutical company). Phase: Phase II and Phase III (Integrated). Countries: Netherlands (ended), Belgium (ended), Czechia (ended), Portugal (ended), Spain (ended), Norway (ended), Sweden (ended), France (ended), Greece (ended), Italy (ended), Finland (ended), Germany (ended).
Therapeutic area(s): Diseases [C] - Neoplasms [C04]
Gender: Female, Male. Age: 18-64 years, 65+ years. Enrolment: 209.
Status: Ended. Start date (EU): 2022-03-25. End date (EU): 2025-11-21. End date: 2026-01-26. Decision date: 2024-09-05. Results received: No. Last updated: 2025-07-04.
Decision dates by country: NO: 2024-09-05, DE: 2024-09-09, FR: 2024-09-05, ES: 2024-09-16, GR: 2024-09-23, PT: 2024-09-06, BE: 2024-09-06, FI: 2024-09-05, CZ: 2024-09-09, IT: 2024-09-18, NL: 2024-09-06, SE: 2024-09-06

Condition(s): Advanced dedifferentiated liposarcoma
Product: BI 907828, BI 907828, Doxorubicin-Ebewe, 2 mg/ml, koncentrat do sporządzania roztworu do infuzji, BI 907828

Primary endpoint: Progression-free survival (PFS). PFS based on central independent review will be assessed at the interim futility analysis at approximately the same time as the end of Phase II, and the primary PFS analysis will take place during the Phase III part.
Endpoint(s): Objective response (OR), defined as a best overall response of confirmed complete response (CR) or confirmed partial response (PR) according to RECIST version 1.1 (based on blinded central independent review) from the date of randomization until disease progression, death, or last evaluable tumor assessment before start of subsequent anti-cancer therapy, loss to follow-up, withdrawal of consent, or end of patient's participation in the trial, whichever occurs first., Duration of objective response (DOR), defined as the time interval from first documented confirmed OR until disease progression or death among patients with confirmed objective response (based on blinded central independent review), whichever occurs first., Overall survival (OS) will be assessed at the end of the Phase III part of the trial. OS is defined as the time interval from randomization until death from any cause., Disease control (DC), defined as a best overall response of CR, PR, or stable disease (SD) according to RECIST version 1.1 (based on blinded central independent review)., Health-Related Quality of Life (HRQoL), based on data collected through specific questionnaires (Patient Reported Outcome Measures, PROMs), analyzed from baseline to Week 6 and to Week 18. The HRQoL endpoints are defined as the scores calculated from data collected through selected EORTC QLQ-C30 domains (physical functioning, pain, fatigue, and global health status / quality of life), fatigue and pain based on items from the EORTC QLQ-C30 and the EORTC Item Library, and the EQ-5D5L., Occurrence of treatment-emergent adverse events (AEs)., Occurrence of treatment-emergent AEs leading to study drug discontinuation.

Source: https://euclinicaltrials.eu/ctis-public/view/2024-511361-11-00